EU clinical trial 2025-521381-10-00: A Phase 3 Randomized, Double-blind, Placebo-Controlled, Parallel Group, Multicenter Protocol in Adults with an Open Label Study in Adolescents to Evaluate the Efficacy and Safety of Induction and Maintenance Therapy with Icotrokinra in Participants With Moderately to Severely Active Ulcerative Colitis
Protocol code: 77242113UCO3001
Sponsor: Janssen Cilag International (Pharmaceutical company). Phase: Therapeutic confirmatory (Phase III). Countries: Netherlands (ongoing, recruiting), Romania (ongoing, recruiting), Italy (ongoing, recruiting), Spain (ongoing, recruiting), Sweden (ongoing, recruiting), Czechia (ongoing, recruiting), Greece (ongoing, recruiting), Hungary (ongoing, recruiting), France (ongoing, recruiting), Portugal (ongoing, recruiting), Belgium (ongoing, recruiting), Germany (ongoing, recruiting), Poland (ongoing, recruiting).
Therapeutic area(s): Diseases [C] - Digestive System Diseases [C06]
Gender: Female, Male. Age: 0-17 years, 18-64 years, 65+ years. Enrolment: 391.
Status: Ongoing, recruiting. Start date (EU): 2025-12-03. Decision date: 2025-12-01. Results received: No. Last updated: 2026-07-30.
Decision dates by country: DE: 2026-03-05, SE: 2025-12-02, GR: 2025-12-02, IT: 2025-12-02, PL: 2025-12-08, NL: 2025-12-04, RO: 2025-12-08, BE: 2025-12-01, FR: 2025-12-02, CZ: 2025-12-04, ES: 2025-12-03, HU: 2026-03-04, PT: 2025-12-02

Condition(s): Moderately to Severely Active Ulcerative Colitis
Product: JNJ-77242113-AAC Placebo tablet, Icotrokinra

Primary endpoint: Induction study (adult): Clinical remission at Week I-12 Maintenance study (adult): Clinical remission at Week M-40 Adolescent study: Clinical remission at Week M-40

Source: https://euclinicaltrials.eu/ctis-public/view/2025-521381-10-00